EU clinical trial 2024-514088-25-00: A Phase 3 Study Comparing Lenalidomide and Daratumumab Subcutaneous Injection (R-Dara SC) vs Lenalidomide and Dexamethasone (Rd) in Frail Subjects with Previously Untreated Multiple Myeloma who are Ineligible for High Dose Therapy.
Protocol code: 2018_16
Sponsor: Centre Hospitalier Universitaire De Lille (Hospital/Clinic/Other health care facility). Phase: Therapeutic confirmatory (Phase III). Countries: France (ongoing, recruitment ended), Belgium (ongoing, recruitment ended).
Therapeutic area(s): Diseases [C] - Neoplasms [C04]
Gender: Female, Male. Age: 65+ years. Enrolment: 294.
Status: Ongoing, recruitment ended. Start date (EU): 2019-10-07. Decision date: 2024-11-28. Results received: No. Last updated: 2024-11-29.
Decision dates by country: BE: 2024-11-28, FR: 2024-11-29

Condition(s): Multiple Myeloma
Product: DEXAMETHASONE, DARZALEX 1800 mg solution for injection, Revlimid 25 mg hard capsules

Primary endpoint: The primary endpoint is PFS time, which is defined as the duration from the date of randomization to either progressive disease, or death, whichever occurs first. Disease progression will be determined according to the 2016 IMWG criteria.
Endpoint(s): Time-to-treatment failure, defined as time from randomization to discontinuation of therapy for any reason including death, progression, toxicity., Time to next treatment, defined as the time from randomization to the start of the next-line treatment., PFS2 time, defined as the time from randomization to progression on the next line of treatment or death, whichever comes first. Disease progression will be based on investigator judgment. For those subjects who are still alive and not yet progressed on the next line of treatment, they will be censored on the last date of follow-up., Overall survival (OS) time, measured from the date of randomization to the date of the subject's death. If the subject is alive or the vital status is unknown at last contact, then the subject's data will be censored at the date the subject was last known to be alive., CR, defined as: - Negative immunofixation of serum and urine, and - Disappearance of any soft tissue plasmacytomas, and - < 5 % plasma cells (PCs) in bone marrow - For those IgG Kappa myeloma subjects with at least ≤2g/l M-protein on 2 consecutive visits, DIRA test will be utilized to confirm daratumumab interference and rule out false positive immunofixation. Patients who have confirmed daratumumab interference, but meet all other clinical criteria for CR, will be considered CR., VGPR or better, defined as VGPR or CR according to the IMWG criteria during or after the study treatment at the time of data cutoff., Overall response, defined as CR or VGPR or PR, according to the IMWG criteria, during or after the study treatment., Collecting all AE (grade 3 or more) since the beginning of treatment until progression., Evaluation of safety data by type, frequency, severity, relation to study drug, as well as changes in vital signs, physical examinations, incidence of treatment emergent adverse events (TEAEs), serious adverse events, abnormal laboratory test results (according to NCI-CTCAE V4.0)., Evaluation of quality of life based on EORTC C30, MY20 and EQ-5D questionnaires filled every 3 months from the C1J1 during the first year then every 6 months until the end of treatment for progression (then 8 and 16 weeks after the end of treatment)., MRD negativity, as measured at 12 months., Event Free Survival, defined as time from randomization to discontinuation of therapy for any reason including death, progression or toxicity

Source: https://euclinicaltrials.eu/ctis-public/view/2024-514088-25-00